EU clinical trial 2023-508030-33-00: A study in two groups of healthy male adult participants to assess how much test medicine (SAR441566) is taken up, degraded and removed by the body and to assess the extent to which SAR441566 becomes available to the body when given by mouth
Protocol code: BEX17850
Sponsor: Sanofi-Aventis Recherche & Developpement (Pharmaceutical company). Phase: Phase I and Phase II (Integrated)- Bioequivalence Study. Countries: Netherlands (ended).
Therapeutic area(s): Diseases [C] - Immune System Diseases [C20]
Gender: Male. Age: 18-64 years. Enrolment: 13.
Status: Ended. Start date (EU): 2024-03-01. End date (EU): 2024-05-15. Decision date: 2024-02-27. Results received: No. Last updated: 2024-05-10.
Decision dates by country: NL: 2024-05-10

Condition(s): Healthy volunteers

Source: https://euclinicaltrials.eu/ctis-public/view/2023-508030-33-00